EU clinical trial 2025-522519-40-00: A Phase 2/3, Randomized, Active-Controlled, Open-Label (Phase 2) and Double-Blind (Phase 3) Study to Evaluate the Antiretroviral Activity, Safety, and Tolerability of Islatravir (ISL) and Ulonivirine (ULO) Once Weekly Compared With Bictegravir/Emtricitabine/Tenofovir Alafenamide (BIC/FTC/TAF) Once Daily in Treatment-Naïve Adult Participants Living With HIV 1
Protocol code: MK-8591B-062
Sponsor: Merck Sharp & Dohme LLC (Pharmaceutical company). Phase: Phase II and Phase III (Integrated). Countries: France (ongoing, recruiting), Spain (ongoing, recruiting).
Therapeutic area(s): Diseases [C] - Virus Diseases [C02]
Gender: Female, Male. Age: 18-64 years, 65+ years. Enrolment: 70.
Status: Ongoing, recruiting. Start date (EU): 2026-03-16. Decision date: 2026-02-16. Results received: No. Last updated: 2026-02-23.
Decision dates by country: FR: 2026-02-16, ES: 2026-02-23

Condition(s): HIV
Product: EMTRICITABINE, TENOFOVIR ALAFENAMIDE AND BICTEGRAVIR, Placebo to BIK/FTC/TAF, islatravir, ulonivirine, MK-8591B, Placebo to 8591B

Primary endpoint: Phase 2: Percentage of Participants With Human Immunodeficiency Virus Type 1 (HIV-1) Ribonucleic Acid (RNA) <50 Copies/mL at Week 24, Phase 2: Percentage of Participants Who Experience an Adverse Event (AE) at Week 24, Phase 2: Percentage of Participants Who Discontinue Study Intervention Due to an AE at Week 24, Phase 3: Percentage of Participants With HIV-1 RNA <50 Copies/mL at Week 48, Phase 3: Percentage of Participants Who Experience an AE at Week 48, Phase 3: Percentage of Participants Who Discontinue Study Intervention Due to an AE at Week 48
Endpoint(s): Phase 2: Percentage of Participants With HIV-1 RNA <50 Copies/mL at Week 48, Phase 2: Percentage of Participants With HIV-1 RNA <50 Copies/mL at Week 96, Phase 2: Percentage of Participants With HIV-1 RNA <200 Copies/mL at Week 24, Phase 2: Percentage of Participants With HIV-1 RNA <200 Copies/mL at Week 48, Phase 2: Percentage of Participants With HIV-1 RNA <200 Copies/mL at Week 96, Phase 2: Mean Change From Baseline in Cluster of Differentiation 4-Positive (CD4+) T-Cell Count at Week 24, Phase 2: Mean Change From Baseline in CD4+ T-Cell Count at Week 48, Phase 2: Mean Change From Baseline in CD4+ T-Cell Count at Week 96, Phase 2: Percentage of Participants Who Experience an AE, Phase 2: Percentage of Participants Who Discontinue Study Intervention Due to an AE, Phase 2: Number of Participants With Evidence of Viral Drug Resistance-Associated Substitutions at Week 24, Phase 2: Number of Participants With Evidence of Viral Drug Resistance-Associated Substitutions at Week 48, Phase 2: Number of Participants With Evidence of Viral Drug Resistance-Associated Substitutions at Week 96, Phase 3: Percentage of Participants With HIV-1 RNA <50 Copies/mL at Week 96, Phase 3: Percentage of Participants With HIV-1 RNA <200 Copies/mL at Week 48, Phase 3: Percentage of Participants With HIV-1 RNA <200 Copies/mL at Week 96, Phase 3: Mean Change From Baseline in CD4+ T-Cell Count at Week 48, Phase 3: Mean Change From Baseline in CD4+ T-Cell Count at Week 96, Phase 3: Percentage of Participants Who Experience an AE, Phase 3: Percentage of Participants Who Discontinue Study Intervention Due to an AE, Phase 3: Number of Participants With Evidence of Viral Drug Resistance-Associated Substitutions at Week 48, Phase 3: Number of Participants With Evidence of Viral Drug Resistance-Associated Substitutions at Week 96, Phase 3: Mean Change From Baseline in Body Weight at Week 48, Phase 3: Mean Change From Baseline in Body Weight at Week 96

Source: https://euclinicaltrials.eu/ctis-public/view/2025-522519-40-00